EU clinical trial 2025-520612-34-00: A Phase 3, Randomized, Double-Blind, Placebo-Controlled, Parallel Group Study to Evaluate the Safety and Efficacy of KarXT + KarX-EC for the Treatment of Agitation Associated with Alzheimer’s Disease (ADAGIO-2)
Protocol code: CN012-0024
Sponsor: Bristol-Myers Squibb Services Unlimited Company (Pharmaceutical company). Phase: Therapeutic confirmatory (Phase III). Countries: Poland (ongoing, recruiting), Hungary (authorised, recruiting), Italy (ongoing, recruiting), France (ongoing, recruiting), Czechia (ongoing, recruiting).
Therapeutic area(s): Psychiatry and Psychology [F] - Mental Disorders [F03]
Gender: Female, Male. Age: 18-64 years, 65+ years. Enrolment: 92.
Start date (EU): 2025-11-28. Decision date: 2025-10-22. Results received: No. Last updated: 2026-03-10.
Decision dates by country: IT: 2025-10-22, FR: 2025-10-24, HU: 2025-10-22, CZ: 2025-10-22, PL: 2025-10-26

Condition(s): Agitation Associated with Alzheimer’s Disease
Product: KarXT, KarX-EC, KarX-EC, KarXT, KarXT, KarX-EC matching Placebo, KarXT matching placebo, KarXT, KarX-EC, KarX-EC

Primary endpoint: Change from baseline to the end of treatment on the CMAI-IPA total score compared with placebo.
Endpoint(s): Change from baseline to the end of treatment on the CGI-S as it relates specifically to agitation compared with placebo.

Source: https://euclinicaltrials.eu/ctis-public/view/2025-520612-34-00